EU clinical trial 2024-513258-31-00: A study to find how well VES001 works and how safe it is in participants with GRN -frontotemporal dementia (GRN-FTD) showing no symptoms
Protocol code: FTD002
Sponsor: Vesper Bio ApS (Pharmaceutical company). Phase: Human Pharmacology (Phase I)- Other. Countries: Netherlands (ended).
Therapeutic area(s): Diseases [C] - Nervous System Diseases [C10]; Phenomena and Processes [G] - Genetic Phenomena [G05]
Gender: Female, Male. Age: 18-64 years, 65+ years. Enrolment: 3.
Status: Ended. Start date (EU): 2024-12-11. End date (EU): 2025-07-08. End date: 2025-08-05. Decision date: 2024-10-28. Results received: No. Last updated: 2025-04-01.

Condition(s): Frontotemporal dementia (FTD)

Source: https://euclinicaltrials.eu/ctis-public/view/2024-513258-31-00